EU clinical trial 2023-509859-13-00: A Phase 3, Two-Stage, Randomized, Multicenter, Open-Label Study Comparing Mezigdomide (CC-92480), Bortezomib And Dexamethasone (MeziVd) Versus Pomalidomide, Bortezomib And Dexamethasone (PVd) In Subjects With Relapsed Or Refractory Multiple Myeloma (RRMM): Successor-1
Protocol code: CA057-001
Sponsor: Celgene Corp. (Pharmaceutical company). Phase: Therapeutic confirmatory (Phase III). Countries: Ireland (ongoing, recruitment ended), Portugal (ongoing, recruitment ended), Greece (ongoing, recruitment ended), France (ongoing, recruitment ended), Czechia (ongoing, recruitment ended), Romania (ongoing, recruitment ended), Germany (ongoing, recruiting), Italy (ongoing, recruitment ended), Finland (ongoing, recruitment ended), Austria (ongoing, recruitment ended), Belgium (ongoing, recruitment ended), Poland (ongoing, recruitment ended), Spain (ongoing, recruitment ended).
Therapeutic area(s): Diseases [C] - Neoplasms [C04]
Gender: Female, Male. Age: 18-64 years, 65+ years. Enrolment: 325.
Start date (EU): 2022-11-09. Decision date: 2024-06-18. Results received: No. Last updated: 2026-06-12.
Decision dates by country: BE: 2024-06-18, CZ: 2024-06-20, DE: 2024-06-19, AT: 2024-07-22, FI: 2024-06-19, IE: 2024-06-18, FR: 2024-06-21, IT: 2024-06-24, ES: 2024-08-29, PL: 2024-08-30, PT: 2024-06-18, RO: 2024-06-20, GR: 2024-08-22

Condition(s): Relapsed or Refractory Multiple Myeloma (RRMM)
Product: DEXAMETHASONE, Imnovid 2 mg hard capsules, CC-92480, Imnovid 1 mg hard capsules, Dexamethason 4 mg JENAPHARM®, CC-92480, Imnovid 4 mg hard capsules, VELCADE 1 mg powder for solution for injection, CC-92480, CC-92480, Dexamethason-ratiopharm® 4 mg Tabletten, Imnovid 3 mg hard capsules, Dexamethason 4 mg GALEN®, Dexamethason CF 20 mg/ml, injectievloeistof, CC-92480, CC-92480

Primary endpoint: Progression free Survival (PFS)
Endpoint(s): Recommended mezigdomide dose, Pharmacokinetics, Overall Survival (OS), Overall Response Rate (OR), Complete Response Rate (CR) or better, Very Good Partial Response Rate (VGPR) or better, Time to Response (TTR), Duration of Response (DOR), Time to Progression (TTP), Time to Next Treatment (TTNT), Progression-free survival 2 (PFS-2), Minimal residual disease (MRD) negativity, Safety, Health Related Quality of Life (HRQoL) Evaluation

Source: https://euclinicaltrials.eu/ctis-public/view/2023-509859-13-00